EU clinical trial 2024-512855-19-00: Evaluation of 64Cu-ATSM PET/CT as a predictor of response to neoadjuvant therapy in locally advanced rectal cancer (TEP-64Cu-ATSM-Rectum)
Protocol code: TEP-64Cu-ATSM-Rectum
Sponsor: Institut De Cancerologie De L Ouest (Hospital/Clinic/Other health care facility). Phase: Therapeutic exploratory (Phase II). Countries: France (ended).
Therapeutic area(s): Diseases [C] - Neoplasms [C04]
Gender: Female, Male. Age: 18-64 years, 65+ years. Enrolment: 70.
Status: Ended. Start date (EU): 2019-04-30. End date (EU): 2026-02-12. Decision date: 2024-06-18. Results received: No. Last updated: 2025-07-07.

Condition(s): Rectal adenocarcinoma

Source: https://euclinicaltrials.eu/ctis-public/view/2024-512855-19-00